EU clinical trial 2025-523464-20-00: A Phase 2b, Multicenter, Randomized, Double-blind, Placebo-controlled, Dose-ranging Study to Evaluate the Efficacy and Safety of JNJ-95597528 for the Treatment of Adult Participants with Moderate to Severe Atopic Dermatitis
Protocol code: 95597528ADM2001
Sponsor: Janssen Cilag International (Pharmaceutical company). Phase: Therapeutic exploratory (Phase II). Countries: Germany (ongoing, recruitment ended), Poland (ended).
Therapeutic area(s): Diseases [C] - Immune System Diseases [C20]
Gender: Female, Male. Age: 18-64 years, 65+ years. Enrolment: 14.
Start date (EU): 2026-05-20. Decision date: 2026-05-19. Results received: No. Last updated: 2026-05-25.
Decision dates by country: PL: 2026-05-25, DE: 2026-05-19

Condition(s): Moderate to Severe Atopic Dermatitis
Product: Placebo for JNJ-95597528, JNJ-95597528

Primary endpoint: EASI 75 at Week 12

Source: https://euclinicaltrials.eu/ctis-public/view/2025-523464-20-00